EU clinical trial 2024-517595-38-00: ASPIRIN - Acetylsalicylic acid versus placebo in addition to a local non-steroidal anti-inflammatory drug in the treatment of thrombotic episodes in superficial venous malformations in children aged 6 to 17 years: a controlled randomised, double-blind, cross-over, multicenter trial
Protocol code: DR200091
Sponsor: Centre Hospitalier Regional Universitaire De Tours (Hospital/Clinic/Other health care facility). Phase: Therapeutic confirmatory (Phase III). Countries: France (authorised, recruitment pending).
Therapeutic area(s): Diseases [C] - Cardiovascular Diseases [C14]
Gender: Female, Male. Age: 0-17 years, 18-64 years. Enrolment: 34.
Status: Authorised, recruitment pending. Decision date: 2026-02-25. Results received: No. Last updated: 2026-02-25.

Condition(s): Thrombotic episodes in superficial venous malformations in children
Product: ASPRO 320 mg, comprimé, CALCIUM HYDROGEN PHOSPHATE DIHYDRATE, DICLOFENAC ARROW 1 %, gel en flacon pressurisé

Primary endpoint: Evaluation of the efficacy on pain of acetylsalicylic acid + local NSAID versus placebo + local NSAID, administered for a period of 3 days to 14 days
Endpoint(s): Cumulative consumption of tier 1 and 2 analgesics (indirect reflection of treatment efficacy) over 14 days, Impact on the child's quality of life (by measuring the C-DLQI - Children-Quality of Life Index and the CLFMQol - specific Quality Of Life measurement tool for Children with Low-Flow Malformations) at baseline, and after each attack, Safety: number of serious and non-serious adverse events in each group, Comparison of the impact of experimental treatment and control treatment on coagulation markers during attacks of superficial venous thrombosis in superficial venous malformations, by measuring : CBC, PT, APTT, plasma fibrinogen and D-dimers, Impact of the malformation on sleep quality (Fast Score SLEEP VASC) measured once a day for 14 days, Functional impairment related to the malformation will be assessed daily using a VAS (visual analog scale, ranging from 0 to 10) (0 no discomfort, 10 maximum discomfort, inability to move a limb or body segment) at baseline and after each follow-up.

Source: https://euclinicaltrials.eu/ctis-public/view/2024-517595-38-00